EU clinical trial 2024-511187-81-00: A Phase 3 Multicenter, Randomized, Openlabel, Active-controlled Study of Sotorasib and Panitumumab Versus Investigator’s Choice (Trifluridine and Tipiracil, or Regorafenib) for the Treatment of Previously Treated Metastatic Colorectal Cancer Subjects with KRAS p.G12C Mutation
Protocol code: 20190172
Sponsor: Amgen Inc. (Pharmaceutical company). Phase: Therapeutic confirmatory (Phase III). Countries: Italy (ended), Germany (ended), Greece (ended), France (ended), Spain (ended).
Therapeutic area(s): Diseases [C] - Neoplasms [C04]
Gender: Female, Male. Age: 18-64 years, 65+ years. Enrolment: 99.
Status: Ended. Start date (EU): 2022-03-28. End date (EU): 2026-04-14. End date: 2026-04-15. Decision date: 2024-10-08. Results received: No. Last updated: 2025-07-17.
Decision dates by country: ES: 2024-10-08, FR: 2024-10-10, GR: 2024-10-24, DE: 2024-10-09, IT: 2024-11-11

Condition(s): Colorectal Cancer (CRC)
Product: SOTORASIB, Stivarga 40 mg film-coated tablets, Lonsurf 20 mg/8.19 mg film-coated tablets, Vectibix 20 mg/ml concentrate for solution for infusion, Stivarga 40 mg film-coated tablets, Vectibix 20 mg/ml concentrate for solution for infusion, Lonsurf 15 mg/6.14 mg film-coated tablets

Primary endpoint: PFS – defined as time from randomization until disease progression or death from any cause, whichever occurs first, for all subjects. Progression will be assessed using Response Evaluation Criteria in Solid Tumors version 1.1 (RECIST v1.1) per Blinded Independent Central Review (BICR)
Endpoint(s): Overall survival - defined as time from randomization until death from any cause, Objective response = complete response (CR) + partial response (PR), assessed per RECIST 1.1. Response will be assessed by BICR. CR and PR require confirmatory repeat assessment at least 4 weeks after the first detection of response, Incidence and severity of treatmentemergent adverse events, changes in vital signs, and changes in clinical laboratory tests, Change from baseline over time to week 8 Fatigue severity measured by item 3 on the brief faigure invetory, Pharmacokinetic (PK) parameters of sotorasib and panitumumab including, but not limited to, maximum plasma concentration (Cmax), area under the plasma concentration-time curve (AUC), Change from baseline over time to 8 weeks for the BFI, BPI and EORTC QLQ-C30. Summary scores and changes from baseline of VAS scores as measured by EuroQol-5D level 5. Summary scores on symptom bother on GP5 from FACT-G. Summary scores of Patient Global Impression of change at each timepoint., Duration of overall response - defined as time from first evidence of PR or CR to disease progression or death due to any cause, whichever occurs first. Progression will be based on BICR per RECIST 1.1

Source: https://euclinicaltrials.eu/ctis-public/view/2024-511187-81-00